EU clinical trial 2025-521775-31-00: A Randomized, Placebo-Controlled, Double-Blind, Multi-Center Phase 3 Study of Zipalertinib Plus Adjuvant Chemotherapy Versus Placebo Plus Adjuvant Chemotherapy in Stage IB-IIIA NSCLC Patients with Uncommon EGFR Mutations Following Complete Tumor Resection (REZILIENT4)
Protocol code: TAS6417-302
Sponsor: Taiho Oncology Inc. (Pharmaceutical company). Phase: Therapeutic confirmatory (Phase III). Countries: Germany (temporarily halted), Poland (temporarily halted), Spain (temporarily halted), France (temporarily halted), Belgium (authorised, recruitment pending), Italy (temporarily halted), Greece (authorised, recruitment pending), Romania (temporarily halted), Netherlands (temporarily halted).
Therapeutic area(s): Diseases [C] - Neoplasms [C04]
Gender: Female, Male. Age: 18-64 years, 65+ years. Enrolment: 141.
Start date (EU): 2025-11-12. Decision date: 2025-10-06. Results received: No. Last updated: 2026-03-11.
Decision dates by country: DE: 2025-10-08, IT: 2025-10-06, PL: 2025-10-10, BE: 2025-10-06, FR: 2025-10-13, ES: 2025-10-13, GR: 2026-02-05, RO: 2026-03-09, NL: 2026-02-06

Condition(s): Stage IB-IIIA NSCLC Patients with uncommon EGFR Mutations
Product: Zipalertinib Placebo Tablets is a film-coated tablet that does not contain the active ingredient, zipalertinib., Cisplatin Hikma 1 mg/ml Konzentrat zur Herstellung einer Infusionslösung, Zipalertinib, Pemetrexed Fresenius Kabi 25 mg/ml concentrate for solution for infusion, Carboplatin Hikma 10 mg/ml Konzentrat zur Herstellung einer Infusionslösung

Primary endpoint: Disease-free survival (DFS) by investigator assessment

Source: https://euclinicaltrials.eu/ctis-public/view/2025-521775-31-00